EU clinical trial 2025-524056-63-00: AMG 436 as monotherapy and combination therapy in participants with Microsatellite Instability-High/Mismatch Repair Deficient Solid Tumors
Protocol code: 20250004
Sponsor: Amgen Inc. (Pharmaceutical company). Phase: Human Pharmacology (Phase I)- First administration to humans. Countries: Spain (ongoing, recruiting), France (ongoing, recruiting), Belgium (ongoing, recruiting).
Therapeutic area(s): Diseases [C] - Neoplasms [C04]
Gender: Female, Male. Age: 18-64 years, 65+ years. Enrolment: 77.
Status: Ongoing, recruiting. Start date (EU): 2026-06-05. Decision date: 2026-04-28. Results received: No. Last updated: 2026-05-08.
Decision dates by country: BE: 2026-04-29, ES: 2026-05-04, FR: 2026-04-28

Condition(s): microsatellite instability high/mismatch repair deficient (MSI-H/dMMR) solid tumors

Source: https://euclinicaltrials.eu/ctis-public/view/2025-524056-63-00